EU clinical trial 2023-509743-27-00: A Double Blind, Randomized, Placebo-Controlled Study to Evaluate the Efficacy and Safety of PRA023 in Subjects with Systemic Sclerosis Associated with Interstitial Lung Disease (SSc-ILD)
Protocol code: PR200-104_MK-7240-00
Sponsor: Prometheus Biosciences Inc. (Pharmaceutical company). Phase: Therapeutic exploratory (Phase II). Countries: Hungary (ongoing, recruitment ended), Spain (ongoing, recruitment ended), Poland (ongoing, recruitment ended), Netherlands (ended), France (ended), Italy (ongoing, recruitment ended), Germany (ended), Belgium (ongoing, recruitment ended).
Therapeutic area(s): Diseases [C] - Immune System Diseases [C20]
Gender: Female, Male. Age: 18-64 years, 65+ years. Enrolment: 103.
Start date (EU): 2022-04-29. Decision date: 2024-07-15. Results received: No. Last updated: 2026-07-14.
Decision dates by country: FR: 2024-07-17, DE: 2024-07-17, NL: 2024-07-15, PL: 2024-08-04, HU: 2024-07-17, BE: 2024-07-17, ES: 2024-07-24, IT: 2024-07-22

Condition(s): Systemic sclerosis associated with interstitial lung disease
Product: tulisokibart, tulisokibart, Placebo is 0.9% normal saline. It is identical to IMP and its pharmaceutical form is solution for infusion.

Primary endpoint: 1.The proportion of subjects reporting adverse events (AEs), serious adverse events (SAEs), AEs leading to discontinuation, and markedly abnormal laboratory values. 2.To compare the annual rate of change from Baseline in FVC in mL of MK-7240/PRA023 vs. placebo over 50 weeks
Endpoint(s): 1.To compare the change from Baseline in FVC in mL of MK-7240/PRA023 vs. placebo at Week 50. 2.To compare the change from Baseline in HRCT QILD-WL of MK-7240/PRA023 vs. placebo at Week 50, 3.To compare proportion of subjects with an improvement in the revised CRISS score of MK-7240/PRA023 vs. placebo at Week 50. 4.To assess the change from Baseline in HAQ-DI of MK-7240/PRA023 vs. placebo at Week 50, To assess the change from Baseline in L-PF patient-reported quality of life (QoL) outcome of MK-7240/PRA023 vs. placebo at Week 50

Source: https://euclinicaltrials.eu/ctis-public/view/2023-509743-27-00